EU clinical trial 2023-508116-32-00: BE-MOBILYZED: BElimumab to MOBIlise memory B-cells from secondary LYmhoid organs to improve memory B-cell HLA-specificity profiling to support delisting for transplant access in highly-sensitiZED.
Sponsor: Academisch Ziekenhuis Leiden (Hospital/Clinic/Other health care facility). Phase: Therapeutic exploratory (Phase II). Countries: Netherlands (ongoing, recruiting).
Therapeutic area(s): Phenomena and Processes [G] - Immune System Phenomena [G13]; Diseases [C] - Immune System Diseases [C20]
Gender: Female, Male. Age: 18-64 years, 65+ years. Enrolment: 25.
Status: Ongoing, recruiting. Start date (EU): 2026-03-17. Decision date: 2025-11-27. Results received: No. Last updated: 2026-08-03.

Condition(s): Antibody-mediated rejection of renal grafts, High HLA-immunization in transplant candidates
Product: Benlysta 200 mg solution for injection in pre-filled syringe.

Primary endpoint: The difference between baseline and after 4 weeks of belimumab therapy in the number of HLA-specificities with targeted antibodies as produced by supernatants of stimulated memory B-cells, detected through Luminex single antigen bead analysis.
Endpoint(s): The difference between baseline and after delisting in the number of unacceptable HLAspecificities, the vPRA and the frequency of matching donors within the Eurotransplant region, as calculated through online available Eurotransplant calculator tools., The number of rejection, DSA development, graft loss or mortality events in patients who were transplanted after the delisting procedure as described in this protocol has taken place., The difference in concordant positive antigens in memory analysis between the two pretreatment assays and the two on-treatment assays., The difference between baseline and after 4 weeks of belimumab therapy in the MFI levels of targeted antibodies as produced by supernatants of stimulated memory B-cells, detected through Luminex SAB analysis., The difference between baseline and after 4 weeks of belimumab therapy in the MFI levels of targeted antibodies in plasma, detected through Luminex SAB analysis., The difference between 4 weeks of belimumab therapy and 12 and 36 weeks thereafter in the number of HLA-specificity specificities with targeted antibodies as produced by supernatants of stimulated memory B-cells, detected through Luminex SAB analysis., The difference in serum BAFF levels in peripheral blood before, during and after belimumab treatment., The difference in phenotypically distinct B-cell subsets in the peripheral circulation at baseline, during 4 weeks of belimumab treatment and 36 weeks thereafter, as measured through flow-cytometry and ELISPOT assays., Differential gene expression and pathway enrichment analysis of sorted B-cell populations (e.g., CD19⁺CD27⁺ B cells) at baseline, during 4 weeks of belimumab treatment and 36 weeks thereafter., The number of adverse events, as defined in Chapter 13, during 4 weeks of belimumab treatment until 84 days thereafter. Adverse events that have led to (temporary) discontinuation of the treatment, as defined by the stop criteria mentioned in paragraph 12.3.1, will be described separately. The number of serious adverse advents during 4 weeks of belimumab treatment and 40 weeks thereafter. All SUSARs until the end of study.

Source: https://euclinicaltrials.eu/ctis-public/view/2023-508116-32-00